EU clinical trial 2023-510279-80-00: CDX0159-10: A Phase 2, Randomized, Double-Blind, Placebo-Controlled Study to Assess the Efficacy and Safety of Barzolvolimab in Patients with Prurigo Nodularis
Protocol code: CDX0159-10
Sponsor: Celldex Therapeutics Inc. (Pharmaceutical company). Phase: Therapeutic exploratory (Phase II). Countries: Spain (ended), Germany (ongoing, recruitment ended), Poland (ongoing, recruitment ended), Croatia (ongoing, recruitment ended).
Therapeutic area(s): Diseases [C] - Skin and Connective Tissue Diseases [C17]
Gender: Female, Male. Age: 18-64 years, 65+ years. Enrolment: 78.
Start date (EU): 2024-09-25. Decision date: 2024-08-13. Results received: No. Last updated: 2026-04-13.
Decision dates by country: DE: 2024-08-13, PL: 2024-08-13, HR: 2025-07-28, ES: 2024-08-13

Condition(s): Prurigo nodularis
Product: BARZOLVOLIMAB, Placebo for this study is the barzolvolimab vehicle (containing 0 mg/mL barzolvolimab)., BARZOLVOLIMAB

Primary endpoint: Main: Proportion of participants with improvement (reduction) in WI-NRS by ≥ 4 from baseline to Week 12., OLE: Incidence and severity of AEs from OLE baseline through Week X40.
Endpoint(s): Main: Proportion of participants with improvement (reduction) in WI-NRS by ≥ 4 from baseline to Week 4, Week 24 and over time., Main: Proportion of participants with IGA-CNPG-S score of 0 or 1 at Weeks 4. 12 and 24., Main: Proportion of participants with improvement (reduction) in WI-NRS by ≥ 4 from baseline and IGA-CNPG-S score of 0 or 1 at Weeks 4, 12 and 24., Main: Proportion of participants with IGA for activity of chronic prurigo (IGA-CPG-A) score of 0 or 1 at Weeks 4, 12 and 24., Main: Absolute and percentage change from baseline in WI-NRS at Weeks 4, 12 and 24., Main: Absolute and percentage change from baseline in Sleep Quality Numerical Rating Scale (SQ-NRS) at Weeks 4, 12 and 24., Main: Absolute and percentage change from baseline in Worst Pain Numerical Rating Scale (WP-NRS) at Weeks 4, 12 and 24., Main: Absolute and percentage change from baseline in PROMIS Fatigue-SF Daily at Weeks 4, 12 and 24., Main: Absolute and percentage change from baseline in DLQI at Weeks 4, 12 and 24., Main: Proportion of participants with WI-NRS score < 2 at Weeks 4, 12 and 24., Main: Proportion of participants with improvement (reduction) in SQ-NRS by ≥ 4 from baseline to Week 4, 12 and 24., Main: Proportion of participants with improvement (reduction) in WP-NRS by ≥ 4 from baseline to Weeks 4, 12 and 24., Main: Proportion of participants with improvement (reduction) of ≥ 4 in DLQI from baseline to Weeks 4, 12 and 24., Main: Proportion of participants achieving DLQI score of 0 or 1 at Weeks 4. 12 and 24., Main: Absolute and percentage change from baseline in PGIS, and PGIS-SD at Weeks 4, 12 and 24., Main: Vital signs, safety laboratory tests, physical examination findings, electrocardiograms (ECGs), and the incidence and severity of adverse events (AEs) throughout the study., Main: Absolute and percentage change from baseline in IGA-CNPG-S at Weeks 4, 12, and 24., Main: PGIC and PGIC-SD (also including the absolute and percentage change from Week 4) at Weeks 4, 12, and 24, OLE: Proportion of participants with improvement (reduction) in weekly average WI-NRS by ≥ 4 from OLE baseline through Week X24, OLE: Proportion of participants with IGA-CNPG-S score of 0 or 1 through Week X24, OLE: Proportion of participants with improvement (reduction) in weekly average WI-NRS by ≥ 4 from OLE baseline and IGA-CNPG-S score of 0 or 1 through Week X24, OLE: Proportion of participants with IGA-CPG-A score of 0 or 1 through Week X24, OLE: Absolute and percentage change in weekly average WI-NRS from OLE baseline through Week X24, OLE: Absolute and percentage change in IGA-CNPG-S from OLE baseline through Week X24, OLE: Absolute and percentage change in weekly average SQ-NRS from OLE baseline through Week X24, OLE: Absolute and percentage change in weekly average WP-NRS from OLE baseline through Week X24, OLE: Absolute and percentage change in weekly average PROMIS Fatigue-SF Daily from OLE baseline through Week X24, OLE: Absolute and percentage change in DLQI from OLE baseline through Week X24, OLE: Proportion of participants with weekly average WI-NRS score < 2 through Week X24, OLE: Proportion of participants with improvement (reduction) in weekly average SQ-NRS by ≥ 4 from OLE baseline through Week X24, OLE: Proportion of participants with improvement (reduction) in weekly average WP-NRS by ≥ 4 from OLE baseline through Week X24, OLE: Proportion of participants with improvement (reduction) of ≥ 4 in DLQI from OLE baseline through Week X24, OLE: Proportion of participants achieving DLQI score of 0 or 1 through Week X24, OLE: Absolute and percentage change in PGIS and PGIS-SD from OLE baseline through Week X24, OLE: PGIC and PGIC-SD (also including the absolute and percentage change from Week X4) at each visit through Week X24

Source: https://euclinicaltrials.eu/ctis-public/view/2023-510279-80-00